EU clinical trial 2025-523076-23-00: Randomized, Double-blind, Placebo-controlled, Proof-of-concept Phase II Trial Investigating the Effect of Valproic Acid in Women with Adenomyosis.
Protocol code: CHP23001
Sponsor: CCDRD Cooperative Clinical Drug Research and Development AG, Nadezhda Reproductive Science OOD (Pharmaceutical company, Laboratory/Research/Testing facility). Phase: Therapeutic exploratory (Phase II). Countries: Bulgaria (authorised, recruitment pending).
Therapeutic area(s): Diseases [C] - Female Urogenital Diseases and Pregnancy Complications [C13]
Gender: Female. Age: 18-64 years. Enrolment: 60.
Status: Authorised, recruitment pending. Decision date: 2026-04-03. Results received: No. Last updated: 2026-04-03.

Condition(s): Adenomyosis
Product: МИГ-400 400 mg филмирани таблетки, НАТРИЕВ ХЛОРИД СОФАРМА 9 mg/ml инжекционен разтвор, Kонвулекс хроно 500 mg таблетки с удължено освобождаване, Конвулекс 100 mg/ml инжекционен разтвор/инфузионен разтвор, Comparator 2: hard gelatine capsules (no active compounds)

Primary endpoint: Pre−post absolute change between baseline and final value after 29 days treatment in AAPP, Final value at the end of 29 days of treatment in the amount of analgesic rescue medication taken (ibuprofen 400 mg tablets)
Endpoint(s): Pre−post absolute change of each pain type associated with adenomyosis (non-menstrual pelvic pain, dysmenorrhea, dyspareunia) as documented on a VAS (in units) at each visit, Clinical Global Impressions (CGI) scale after EoT on Day 30 (+4 days) visit), Patient Global Impression of Change (PGIC) scale after EoT on Day 30 (+4 days) visit), Pre−post absolute change in the lesion(s) size after EoT on Day 30 (+4 days) visit), Pregnancy rate after the first in vitro fertilization cycle performed after a wash-out period of at least 30 days after the end of treatment

Source: https://euclinicaltrials.eu/ctis-public/view/2025-523076-23-00